EU clinical trial 2024-517573-24-00: FUTURE platform trial – A phase II platform trial of futibatinib in combination with (chemo)immunotherapy in colorectal cancer and other solid tumor entities
Protocol code: FUTURE
Sponsor: Frankfurter Institut Fuer Klinische Krebsforschung IKF GmbH (Pharmaceutical company). Phase: Therapeutic exploratory (Phase II). Countries: Germany (ongoing, recruiting).
Therapeutic area(s): Diseases [C] - Neoplasms [C04]
Gender: Female, Male. Age: 18-64 years, 65+ years. Enrolment: 33.
Status: Ongoing, recruiting. Start date (EU): 2025-12-08. Decision date: 2025-08-05. Results received: No. Last updated: 2026-06-12.

Condition(s): Colorectal cancer
Product: 5-FU medac 50 mg/ml, Injektionslösung, Leucovorin 10 mg/ml Lösung zur Injektion/ Infusion, Oxaliplatin Kabi 5 mg/ml Konzentrat zur Herstellung einer Infusionslösung, Tislelizumab, Futibatinib

Primary endpoint: Objective response rate (ORR), defined as rate of patient who achieved complete or partial response (CR+PR) according to RECIST v1.1 as best response.
Endpoint(s): Duration of response (DoR), Progression free survival (PFS) according to RECIST v1.1, Overall survival (OS), Safety, Quality of life using EORTC QLQ-C30

Source: https://euclinicaltrials.eu/ctis-public/view/2024-517573-24-00